EU clinical trial 2024-520051-24-00: POP-ELA: A short-term preoperative, window-of-opportunity study, evaluating activity and safety of Elacestrant monotherapy as compared to Elacestrant + ovarian function suppression (LHRH agonist) in premenopausal patients with stage I-II ER+/HER2- breast cancer
Protocol code: CSET 2025/4053
Sponsor: Institut Gustave Roussy (Hospital/Clinic/Other health care facility). Phase: Therapeutic exploratory (Phase II). Countries: France (ongoing, recruiting).
Therapeutic area(s): Diseases [C] - Neoplasms [C04]
Gender: Female. Age: 18-64 years. Enrolment: 140.
Status: Ongoing, recruiting. Start date (EU): 2025-09-30. Decision date: 2025-08-18. Results received: No. Last updated: 2026-07-24.

Condition(s): Breast cancer
Product: Elacestrant, ZEULIDE 3,75 mg, poudre et solvant pour suspension injectable à libération prolongée

Primary endpoint: Change from baseline in Ki67 (the percentage of immunostaining cells).
Endpoint(s): Evaluation of clinical and biological response in the 2 arms by: • Complete cell cycle arrest as measured by Ki67 <2.7% • Clinical response (partial or complete) as measured by MRI • Rate of pathological partial and complete response at surgery • Changes in the levels of estradiol, FSH, and LH between baseline, D14, and D28, then postoperatively at 1 month., Incidence, duration, and severity of treatment-emergent Adverse Events (AEs) assessed by the NCI Common Terminology for Classification of Adverse Events (CTCAE) version 5.0, including dose delays and treatment discontinuations. Incidence of ovarian cyst occurrence up to 6 months after surgery, assessed by CTCAE version 5.0

Source: https://euclinicaltrials.eu/ctis-public/view/2024-520051-24-00